EU clinical trial 2022-501181-22-01: Preoperative treatment with mFOLFIRINOX (or Gem-Nab-P) +/- isotoxic high-dose Stereotactic Body Radiation Therapy (iHD-SBRT) for borderline resectable pancreatic adenocarcinoma: a randomised comparative multicentre phase II study (STEREOPAC)
Protocol code: STEREOPAC-001
Sponsor: Hopital Erasme (Hospital/Clinic/Other health care facility). Phase: Therapeutic exploratory (Phase II). Countries: Belgium (ongoing, recruiting).
Therapeutic area(s): Diseases [C] - Digestive System Diseases [C06]
Gender: Female, Male. Age: 18-64 years, 65+ years. Enrolment: 256.
Status: Ongoing, recruiting. Start date (EU): 2023-02-06. Decision date: 2022-11-09. Results received: No. Last updated: 2026-05-26.

Condition(s): Pancreatic adenocarcinoma
Product: Folinate EG 100mg/10ml oplossing voor injectie, OXALIPLATIN, Fluorouracil Accord Healthcare 50 mg/ml oplossing voor injectie of infusie, Abraxane 5 mg/ml powder for dispersion for infusion., Fluorouracil Accord Healthcare 50 mg/ml oplossing voor injectie of infusie, Fluorouracil Accord Healthcare 50 mg/ml oplossing voor injectie of infusie, Fluorouracil Accord Healthcare 50 mg/ml oplossing voor injectie of infusie, CALCIUM FOLINATE, Irinotecan AB 20 mg/ml solution à diluer pour perfusion, Oxaliplatin Accord Healthcare 5 mg/ml concentraat voor oplossing voor infusie, Oxaliplatin Accord Healthcare 5 mg/ml concentraat voor oplossing voor infusie, PACLITAXEL, FOLINIC ACID, Folinate EG 100mg/10ml oplossing voor injectie, Gemcitabine AB 40 mg/ml, concentraat voor oplossing voor infusie, OXALIPLATIN, PACLITAXEL, FLUOROURACIL, IRINOTECAN HYDROCHLORIDE TRIHYDRATE, Folinate EG 100mg/10ml oplossing voor injectie, GEMCITABINE, Irinotecan AB 20 mg/ml solution à diluer pour perfusion, Gemcitabine AB 40 mg/ml, concentraat voor oplossing voor infusie, Abraxane 5 mg/ml powder for dispersion for infusion., Irinotecan AB 20 mg/ml solution à diluer pour perfusion, Gemcitabine AB 40 mg/ml, concentraat voor oplossing voor infusie, Fluorouracil Accord Healthcare 50 mg/ml oplossing voor injectie of infusie, IRINOTECAN, FLUOROURACIL, Oxaliplatin Accord Healthcare 5 mg/ml concentraat voor oplossing voor infusie, Irinotecan AB 20 mg/ml solution à diluer pour perfusion, Folinate EG 100mg/10ml oplossing voor injectie, GEMCITABINE

Primary endpoint: Residual tumour (R)0 resection, Disease-free-survival
Endpoint(s): Resection rate, Locoregional failure free interval, Distant metastases free interval, Toxicity, Incidence of adverse events, Complete feasibility of the therapeutic sequence, Overall survival, Pathologic complete/major response rate (pCR), Quality of life assessment, Postoperative complications rate, Technical and quality success rate of EUS-delivered fiducials

Source: https://euclinicaltrials.eu/ctis-public/view/2022-501181-22-01